EU clinical trial 2024-514072-40-00: Evaluation of the effect of tacrolimus on carbohydrate metabolism in pre-renal transplantation dialysis patients
Protocol code: CHD045-17
Sponsor: Centre Hospitalier Departemental Vendee (Hospital/Clinic/Other health care facility). Phase: Therapeutic use (Phase IV). Countries: France (ended).
Therapeutic area(s): Analytical, Diagnostic and Therapeutic Techniques and Equipment [E] - Investigative Techniques [E05]; Phenomena and Processes [G] - Metabolism [G03]
Gender: Female, Male. Age: 18-64 years, 65+ years. Enrolment: 20.
Status: Ended. Start date (EU): 2019-03-08. End date (EU): 2026-04-08. Decision date: 2024-06-12. Results received: No. Last updated: 2025-10-28.

Condition(s): Hemodialysis
Product: TACROLIMUS

Primary endpoint: Significant change in glycemic profile between D0 (before the start of treatment) and D14 (after 14 days of tacrolimus treatment)

Source: https://euclinicaltrials.eu/ctis-public/view/2024-514072-40-00